EU clinical trial 2024-514275-18-00: ENRICH - Randomised, open label study of Rituximab/Ibrutinib vs Rituximab/Chemotherapy in older patients with untreated mantle cell lymphoma
Protocol code: PenCTU: 10239
Sponsor: Region Skane, University Hospitals Plymouth NHS Trust (Hospital/Clinic/Other health care facility). Phase: Phase II and Phase III (Integrated). Countries: Denmark (ongoing, recruitment ended), Norway (ongoing, recruitment ended), Sweden (ongoing, recruitment ended), Finland (ongoing, recruitment ended).
Therapeutic area(s): Diseases [C] - Hemic and Lymphatic Diseases [C15]
Gender: Female, Male. Age: 18-64 years, 65+ years. Enrolment: 135.
Status: Ongoing, recruitment ended. Start date (EU): 2017-12-06. Decision date: 2024-09-11. Results received: No. Last updated: 2025-09-22.
Decision dates by country: DK: 2024-09-11, FI: 2024-09-12, SE: 2024-09-11, NO: 2024-09-12

Condition(s): Mantle Cell Lymphoma (MCL)
Product: DOXORUBICIN HYDROCHLORIDE, VINCRISTINE SULFATE, CYCLOPHOSPHAMIDE, IMBRUVICA 140 mg hard capsules, BENDAMUSTINE HYDROCHLORIDE, PREDNISOLONE

Primary endpoint: The primary endpoint is progression-free survival (PFS). This is defined as the interval from the date of randomisation to the earlier of the first documentation of disease progression / relapse or death from any cause
Endpoint(s): Overall survival will be measured from the date of randomisation to the date of death from any cause, Disease response will be assessed in accordance with the International Workshop Standardized Response Criteria for Non-Hodgkin's Lymphoma. Response assessments are to be guided by the Cheson Criteria 1999. Disease response will be formally assessed by CT scans and Bone Marrow biopsies, Safety and toxicity - based on adverse events graded by Common Terminology Criteria for Adverse Event reporting (CTCAE) v4.03 and determined by routine clinical assessment, Quality of life - EORTC QLQ-C30 will be used to measure participant assessed quality of life, Time to next MCL treatment is defined as the interval from the date of randomisation to the start date of next MCL treatment or the date of death from any cause

Source: https://euclinicaltrials.eu/ctis-public/view/2024-514275-18-00